EU clinical trial 2023-505726-34-02: Studies to gain insight how the drugs PCSK9-inhibitors and statins affect cholesterol and bile acid metabolism
Sponsor: Karolinska University Hospital (Hospital/Clinic/Other health care facility). Phase: Therapeutic use (Phase IV). Countries: Sweden (authorised, recruitment pending).
Therapeutic area(s): Phenomena and Processes [G] - Metabolism [G03]
Gender: Male. Age: 18-64 years. Enrolment: 8.
Status: Authorised, recruitment pending. Decision date: 2024-04-12. Results received: No. Last updated: 2025-03-10.

Condition(s): Healthy volunteers
Product: EVOLOCUMAB, ATORVASTATIN

Primary endpoint: Changes in the measured parameters of cholesterol and bile acid metabolism

Source: https://euclinicaltrials.eu/ctis-public/view/2023-505726-34-02